EU clinical trial 2024-517977-26-00: Effects of continued administration of empagliflozin in patients with heart failure on active SGLT2 inhibitor treatment admitted for acute decompensated heart failure
Protocol code: EMPA-CON_ZKSJ0162
Sponsor: Friedrich-Schiller-Universitaet Jena (Educational Institution). Phase: Therapeutic confirmatory (Phase III). Countries: Germany (ongoing, recruiting).
Therapeutic area(s): Diseases [C] - Cardiovascular Diseases [C14]
Gender: Female, Male. Age: 18-64 years, 65+ years. Enrolment: 556.
Status: Ongoing, recruiting. Start date (EU): 2025-11-25. Decision date: 2025-08-20. Results received: No. Last updated: 2026-08-03.
Decision dates by country: DE: 2025-10-06

Condition(s): acute decompensated heart failure
Product: Placebo tablet, matching film-coated tablets for oral use, Jardiance 10 mg film-coated tablets

Primary endpoint: The study uses a four-step hierarchical composite primary endpoint: 1) time to all-cause death (day 90) 2) number of heart failure events per patient (day 90) 3) time to first heart failure event (day 90) 4) eGFR decrease from baseline to day 90 (with a between-patient threshold defined as ≥5 ml/min/1.73 m²)
Endpoint(s): Cardiovascular and total mortality on day 90, Number of patients alive and without re-hospitalization on day 90, Re-hospitalization after initial discharge, including reason (time to first re-hospitalization after discharge, numbers of re-hospitalizations), Number of patients with a decrease in eGFR of 5 ml/min/1.73 m² or more from baseline to day 90, Daily and cumulative urine output (UOP) measured from day 1 to day 6, Diuretic efficiency (ml urine per mg furosemide equivalent) from day 1 to day 6, Change in body weight from baseline to day 1, day 3, day 6, discharge, day 30, and day 90, Renal function at baseline, day 3, day 6, day 30, and day 90 : •Decrease in eGFR of >20 ml/min/1.73 m2 •Doubling of serum creatinine •Need for renal replacement therapy •Total urinary sodium excretion and fractional excretion of sodium, Liver function (bilirubin, serum aminotransferases, relevant change in coagulation status) at baseline, day 3, day 6, day 30, and day 90, Change in NT-proBNP (alternatively calculated from BNP) from baseline to day 6, day 30, and day 90, Quality of life (EQ-5D-3L questionnaire) on day 0, at hospital discharge, and on day 30, Severity of HF (KCCQ-12 questionnaire) on day 0, at hospital discharge, and on day 30, IMC / ICU and hospital length of stay, Single parameters of primary endpoint

Source: https://euclinicaltrials.eu/ctis-public/view/2024-517977-26-00